EU clinical trial 2024-515626-92-00: MEMMAT - Medulloblastoma European Multitarget Metronomic Anti-Angiogenic Trial - A Phase II study of metronomic and targeted anti-angiogenesis therapy for children with recurrent/progressive medulloblastoma, ependymoma, ATRT and rare CNS tumors
Sponsor: Medical University Of Vienna (Educational Institution). Phase: Therapeutic exploratory (Phase II). Countries: Austria (ongoing, recruiting), Czechia (ongoing, recruiting), France (ongoing, recruiting), Norway (ongoing, recruiting), Spain (ongoing, recruiting), Sweden (ongoing, recruiting), Denmark (ongoing, recruiting).
Therapeutic area(s): Diseases [C] - Nervous System Diseases [C10]; Diseases [C] - Neoplasms [C04]
Gender: Female, Male. Age: 0-17 years, 18-64 years. Enrolment: 100.
Status: Ongoing, recruiting. Start date (EU): 2013-10-18. Decision date: 2024-10-09. Results received: No. Last updated: 2026-03-25.
Decision dates by country: AT: 2024-10-14, ES: 2024-10-11, DK: 2024-10-10, CZ: 2024-10-11, NO: 2024-10-09, SE: 2024-10-11, FR: 2024-10-11

Condition(s): recurrent/progressive medulloblastoma, ependymoma and atypical teratoid rhabdoid tumor (ATRT), rare CNS tumors
Product: Cyclophosphamide Injection 1 g., Lipcor 200 mg-Kapseln, Temozolomide Accord 100 mg hard capsules., Thalidomide 50 mg capsules, hard, Eto-GRY® 20 mg/ml Konzentrat zur Herstellung einer Infusionslösung, Temozolomide Accord 20 mg hard capsules., Avastin 25 mg/ml concentrate for solution for infusion., Cytarabine 100 mg/ml Solution for Injection, CELEBREX® 200 mg Hartkapseln, Etoposid Ebewe 20 mg/ml - Konzentrat zur Herstellung einer Infusionslösung, ARA-cell® 40 mg Injektion 20 mg/ml Injektionslösung / Konzentrat zur Herstellung einer Infusionslösung, Irinotecan 20 mg/ml Concentrate for Solution for Infusion, Temozolomide Accord 5 mg hard capsules.

Primary endpoint: π: probability for response, lack of recurrence after gross total resection. Stratum II+III: H0: π≤15% study therapy is considered as ineffective (type I error rate α=0.05, two sided). H1: π≥35% study therapy is considered as effective (type II error rate β=0.10 in Stratum I, β=0.20 in Stratum II+III). Stratum IV: H0: π1≤ π2 study therapy is considered as equal or inferior (type I error rate α=0.025, one sided). H1: π1>π2 study therapy is consididered as superior (type II error rate β=0.20)
Endpoint(s): Kaplan Meier survival estimates of overall survival rates after 6, 12, 24, and 36 months with 95% confidence intervals will be evaluated and compared to historical samples, Kaplan Meier estimates of progression free survival after 6, 12, 24, and 36 months with 95% confidence intervals will be evaluated and compared to historical samples, The number and relative frequency of toxicities (CTCAE Version 5.0 grade 3, 4 and 5) will be evaluated every 12 weeks., Performance status will be compared from the start of therapy and every 12 weeks, Subscale-scores and total scores of the KINDL assessments at the start of therapy, after 6 months 12 months, 18 months and 24 months of therapy will be evaluated. PRO will be evaluated every two weeks., The aforementioned variables will be evaluated comparing their influence on response rate, overall survival rate, progression free survival rate, toxicity, quality of life and performance status by multivariate cox-regression, Examination of predictive and prognostic factors will be descriptive.

Source: https://euclinicaltrials.eu/ctis-public/view/2024-515626-92-00